EU clinical trial 2023-510487-12-00: A Double-blind, Placebo-controlled Phase IIa Study to Evaluate the Efficacy and Safety of AZD7798 in Patients with Moderate to Severe Crohn’s Disease (AMALTHEA)
Protocol code: D9690C00005
Sponsor: AstraZeneca AB (Pharmaceutical company). Phase: Therapeutic exploratory (Phase II). Countries: Romania (ended), Austria (ended), Slovakia (ended), Germany (ended), Hungary (ongoing, recruitment ended), Sweden (ongoing, recruitment ended), Italy (ongoing, recruitment ended), Netherlands (ongoing, recruitment ended), France (ongoing, recruitment ended), Bulgaria (ongoing, recruitment ended), Belgium (ended), Poland (ongoing, recruitment ended), Croatia (ended), Spain (ended).
Therapeutic area(s): Diseases [C] - Digestive System Diseases [C06]
Gender: Female, Male. Age: 18-64 years, 65+ years. Enrolment: 77.
Start date (EU): 2024-11-29. Decision date: 2024-10-29. Results received: No. Last updated: 2026-07-06.
Decision dates by country: IT: 2024-11-13, PL: 2024-11-13, DE: 2024-10-31, RO: 2024-11-04, AT: 2024-11-04, HR: 2024-10-31, ES: 2024-11-13, HU: 2025-01-27, BE: 2024-10-29, NL: 2024-11-13, SE: 2024-11-13, SK: 2024-10-30, FR: 2024-11-13, BG: 2024-11-13

Condition(s): Crohn's Disease
Product: AZD7798 Placebo, AZD7798

Primary endpoint: CDAI remission (CDAI score < 150)
Endpoint(s): Endoscopic response (> 50% decrease from baseline in Simple Endoscopic Score for Crohn’s Disease (SES-CD) total score). Participants who meet definition of endoscopic remission will be considered to also have met endoscopic response., Endoscopic remission *SES-CD total score ≤ 2 OR *SES-CD total score ≤ 4 (≤ 2 with ileal/ileocecal disease) and at least 2-point decrease from baseline with no individual subscore > 1, Endoscopic score change from baseline, CDAI response (≥ 100 points decrease from the baseline CDAI or CDAI score < 150 points), CDAI score change from baseline, Symptomatic remission (average daily stool frequency ≤ 2.8 AND average daily abdominal pain ≤ 1, and neither worse than baseline), Serum AZD7798 concentration and incidence and titre of anti-drug antibody (ADA) response

Source: https://euclinicaltrials.eu/ctis-public/view/2023-510487-12-00